EU clinical trial 2025-523778-17-00: A study to compare how the body absorbs 4 different forms of norucholic acid medicine (tablets, granules, and capsules) when taken with or without food in healthy adults
Protocol code: NUT-016/BIO
Sponsor: Dr. Falk Pharma GmbH (Pharmaceutical company). Phase: Human Pharmacology (Phase I)- Other. Countries: Germany (ongoing, recruiting).
Therapeutic area(s): Not possible to specify
Gender: Female, Male. Age: 18-64 years. Enrolment: 32.
Status: Ongoing, recruiting. Start date (EU): 2026-07-14. Decision date: 2026-06-30. Results received: No. Last updated: 2026-07-08.

Condition(s): Not applicable, healthy volunteers

Source: https://euclinicaltrials.eu/ctis-public/view/2025-523778-17-00